EU clinical trial 2026-525862-23-00: Evaluation of the effect of botulinum toxin on refractory upper limb rest tremor in parkinsonian patients, double-blind, placebo-controlled cross-over study : TOX PARK
Protocol code: RC31/25/0444
Sponsor: Centre Hospitalier Universitaire De Toulouse (Hospital/Clinic/Other health care facility). Phase: Therapeutic exploratory (Phase II). Countries: France (authorised, recruitment pending).
Therapeutic area(s): Diseases [C] - Nervous System Diseases [C10]
Gender: Female, Male. Age: 18-64 years, 65+ years. Enrolment: 39.
Status: Authorised, recruitment pending. Decision date: 2026-07-24. Results received: No. Last updated: 2026-07-24.

Condition(s): parkinson disease
Product: Dysport 500 U, poudre pour solution injectable, Entonox 50%/50% gaz medicinal comprimat, NaCl

Primary endpoint: The primary endpoint is the Patient Global Impression-Change (PGI-C) score completed by the patient compared between botulinum toxin injection and placebo injection at 6weeks after the injection on treatment-refractory resting tremor of the upper limb, in patients with PD
Endpoint(s): 1. The effect of botulinum toxin: a. on resting tremor will be measured by: i. The change score on the CGI-C (Clinician Global Impression-Change) investigator scale, at six weeks post-injection; ° The delta of the severity scores on the CGI-S (Clinician Global Impression-Severity) investigator scale between injection and six weeks post-injection; ° The delta of the score of item 3.17 (amplitude) on the MDS-UPDRS III investigator scale between injection and six weeks post-injection; ii. The de, The effect of botulinum toxin on the patient's experience will be measured by: a. The delta of the patient's quality of life score on the PDQ-39 self-questionnaire between the injection and six weeks post-injection b. The delta of the activities of daily living score using the MDS-UPDRS part two scale between injection and six weeks post-injection, Safety of use will be measured by: a. The delta of the measurement in Newtons of the manual dynamometer, for the treated hand, between the injection and six weeks post-injection The delta of the scores for severity of muscle weakness in the treated hand, using the PGI-S scale (Patient Global Impression-Severity) completed by the patient between the injection and six weeks post-injection Collection of adverse events throughout the duration of the study

Source: https://euclinicaltrials.eu/ctis-public/view/2026-525862-23-00